EU clinical trial 2023-504259-29-00: Bioequivalence of Ulipristal 30 mg Tablets in Healthy Subjects Under Fed Conditions
Protocol code: BLCL-ULI-FDA-02
Sponsor: Laboratorios Leon Farma S.A. (Pharmaceutical company). Phase: Human Pharmacology (Phase I)- Bioequivalence Study. Countries: Portugal (ended).
Therapeutic area(s): Not possible to specify
Gender: Female. Age: 18-64 years. Enrolment: 44.
Status: Ended. Start date (EU): 2024-03-18. End date (EU): 2024-06-25. Decision date: 2023-05-29. Results received: No. Last updated: 2024-02-27.

Condition(s): No medical condition

Source: https://euclinicaltrials.eu/ctis-public/view/2023-504259-29-00